EU clinical trial 2022-501952-27-00: A Multicenter, Randomized, Double-Blind, Comparative, Phase 3 Study to Evaluate the Efficacy and Safety of Intravenous Imipenem/Cilastatin-XNW4107 in Comparison with Imipenem/Cilastatin/Relebactam in Adults with Hospital-Acquired Bacterial Pneumonia or Ventilator-Associated Bacterial Pneumonia
Protocol code: XNW4107-302
Sponsor: Evopoint Biosciences USA Inc. (Pharmaceutical company). Phase: Therapeutic confirmatory (Phase III). Countries: France (ended), Spain (ended).
Therapeutic area(s): Diseases [C] - Bacterial Infections and Mycoses [C01]
Gender: Female, Male. Age: 18-64 years, 65+ years. Enrolment: 58.
Status: Ended. Start date (EU): 2024-04-19. End date (EU): 2024-07-26. End date: 2024-09-29. Decision date: 2023-05-03. Results received: Yes. Last updated: 2024-08-21.
Decision dates by country: FR: 2023-05-03, ES: 2023-05-11

Condition(s): Hospital-acquired bacterial pneumonia (HABP), including ventilated HABP (vHABP) and ventilator-associated bacterial pneumonia (VABP) caused by Gram-negative bacteria
Product: XNW4107, IMIPENEM, CILASTATIN, RECARBRIO

Primary endpoint: The primary endpoint is the Day 14 all-cause mortality rate in the MITT population
Endpoint(s): Day 28 all-cause mortality rate in the MITT population, Day 14 and Day 28 all-cause mortality rate in the micro-MITT, extended micro-MITT, CE, ME, and CR-MITT populations, The proportion of subjects with clinical success as evaluated by the investigator at Day 4, EOT, TOC, and LFU visits in the MITT, micro-MITT, extended micro-MITT, CE, ME, and CR-MITT populations, The proportion of subjects with microbiological success at EOT, TOC, and LFU visits in the micro-MITT, extended micro-MITT, CR-MITT, and ME populations, The proportional of subjects with microbiological success by pathogen at EOT, TOC, and LFU visits in the micro-MITT, extended micro-MITT, ME, and CR-MITT populations, The proportion of subjects with overall success at EOT, TOC, and LFU visits in the micro-MITT, extended micro-MITT, ME, and CR-MITT populations

Source: https://euclinicaltrials.eu/ctis-public/view/2022-501952-27-00